EU clinical trial 2023-508793-29-00: A study in subjects with gout flares that investigates the effect, safety, tolerability, and pharmacokinetics (absorption, distribution, metabolism, and elimination) of a single dose of LEO 158968, a new compound that may potentially be used in the treatment of several autoinflammatory diseases
Protocol code: LP0189-2318
Sponsor: Leo Pharma A/S (Pharmaceutical company). Phase: Human Pharmacology (Phase I)- Other. Countries: Netherlands (ended), France (ended).
Therapeutic area(s): Diseases [C] - Musculoskeletal Diseases [C05]
Gender: Male. Age: 18-64 years, 65+ years. Enrolment: 13.
Status: Ended. Start date (EU): 2025-01-07. End date (EU): 2025-08-07. End date: 2025-09-18. Decision date: 2024-09-10. Results received: No. Last updated: 2025-04-03.
Decision dates by country: NL: 2024-09-16, FR: 2024-09-10

Condition(s): Gout flares

Source: https://euclinicaltrials.eu/ctis-public/view/2023-508793-29-00